EU clinical trial 2024-519795-11-00: APG777-202 - A Long-term Extension Study to Evaluate the Safety and Efficacy of APG777 in Patients With Atopic Dermatitis Previously Treated With APG777
Protocol code: APG777-202
Sponsor: Apogee Therapeutics Inc. (Pharmaceutical company). Phase: Therapeutic exploratory (Phase II). Countries: Poland (ongoing, recruiting), Czechia (ongoing, recruiting), France (authorised, recruitment pending), Germany (ongoing, recruiting), Hungary (ongoing, recruiting), Spain (ongoing, recruiting).
Therapeutic area(s): Diseases [C] - Skin and Connective Tissue Diseases [C17]
Gender: Female, Male. Age: 18-64 years, 65+ years. Enrolment: 175.
Start date (EU): 2025-10-06. Decision date: 2025-08-11. Results received: No. Last updated: 2026-08-07.
Decision dates by country: CZ: 2026-02-02, FR: 2026-01-07, HU: 2026-01-15, PL: 2025-08-11, DE: 2026-02-09, ES: 2026-02-12

Condition(s): Atopic Dermatitis
Product: Placebo, APG777

Primary endpoint: Number of Participants with Treatment Emergent Adverse Events [Time Frame: Up to 3 years]
Endpoint(s): Percentage of Participants who achieve Eczema Area and Severity Index (EASI) 50, 75, 90, and 100 calculated based on Parent Study Baseline [Time Frame: Through Extended Treatment Period, an average of 2 years], Percentage of Participants who achieve a validated Investigator Global Assessment Atopic Dermatitis (vIGA-AD) score of 0 (clear) or 1 (almost clear) and a ≥ 2-point reduction as calculated based on Parent Study Baseline. [Time Frame: Through Extended Treatment Period, an average of 2 years], Percentage of Participants who achieve ≥ 4-point improvement in the weekly mean of the daily Itch Numeric Rating Scale (I-NRS) as calculated based on Parent Study Baseline [Time Frame: Through Extended Treatment Period, an average of 2 years], Percentage of Participants who use Rescue Therapy [Time Frame: Through Extended Treatment Period, an average of 2 years], Percentage of Participants Who Continue to Exhibit EASI 75 Of the participants who achieve EASI 75 at Week 52 of the Parent Study, the percentage that continue to exhibit EASI 75 will be determined [Time Frame: From Week 52 Through Extended Treatment Period, an average of 2 years], Percentage of Participants Who Continue to Exhibit vIGA-AD Response Of the participants who achieve vIGA-AD of clear (0) or almost clear (1) and a ≥ 2-Point reduction at Week 52 of the Parent Study, the percentage that continue to exhibit the response will be determined. [Time Frame: From Week 52 Through Extended Treatment Period, an average of 2 years], Percentage of Participants Who Continue to Exhibit I-NRS Response Of the participants who achieve a ≥ 4-point improvement in the weekly mean of the daily I NRS at Week 52 of the Parent Study, the percentage that continue to exhibit the response will be determined. [Time Frame: From Week 52 Through Extended Treatment Period, an average of 2 years], Number of Participants who Discontinued Treatment Due to Treatment-Related TEAEs and SAEs [Time Frame: Up to 3 years], Serum Concentrations of APG777 Over Time [Time Frame: Up to 3 years], Predose Serum Concentrations of APG777 [Time Frame: Up to 3 years]

Source: https://euclinicaltrials.eu/ctis-public/view/2024-519795-11-00